EU clinical trial 2023-505840-20-00: A Phase 1/2 Study to Evaluate the Safety and Efficacy of AZD0486 in Adolescent and Adult Participants with Relapsed or Refractory B-Cell Acute Lymphoblastic Leukaemia
Protocol code: D7405C00001 (SYRUS)
Sponsor: Astrazeneca AB (Pharmaceutical company). Phase: Phase I and Phase II (Integrated)- Other. Countries: Germany (temporarily halted), Italy (temporarily halted), Spain (temporarily halted), France (temporarily halted).
Therapeutic area(s): Diseases [C] - Hemic and Lymphatic Diseases [C15]
Gender: Female, Male. Age: 0-17 years, 18-64 years, 65+ years. Enrolment: 69.
Status: Temporarily halted. Start date (EU): 2024-08-16. Decision date: 2024-04-30. Results received: No. Last updated: 2026-03-02.
Decision dates by country: IT: 2024-06-07, ES: 2024-04-30, DE: 2024-05-06, FR: 2024-05-03

Condition(s): B-Cell Acute Lymphoblastic Leukaemia
Product: AZD0486, AZD0486, TOCILIZUMAB

Primary endpoint: Part A: Frequency of DLTs, Part A,B Safety Evaluation of AZD0486, Part B, C: Rate of CR within 3 cycles
Endpoint(s): Part A: Rate of CR within 3 cycles, Part A,B,C: Rate of CR/CRh and CR/CRh/CRi within 3 cycles, Part A,B,C: Rate of CR, CR/CRh and CR/CRh/CRi at any time during study, Part A, B, C: Duration of CR, CR/CRh and CR/CRh/CRi, Part A, B, C: Event-free survival (EFS), Part A, B, C: Overall Survival (OS), Part B, C: Subsequent alloSCT or donor lymphocyte infusion if used as an alloSCT substitute, Part A, B, C: MRD-negative rate of CR, CR/CRh and CR/CRh/CRi, Part A, B, C: PK Characterization of AZD0486 (UC, Cmax, tmax, Ctrough, t1/2 and CL of AZD0486), Part A, B, C: ADA Characterization of AZD0486

Source: https://euclinicaltrials.eu/ctis-public/view/2023-505840-20-00